EU clinical trial 2025-523544-12-00: A Phase 3, Multicenter, Open-Label, Randomized Trial to Compare the Efficacy and Safety of Elritercept versus Epoetin Alfa for the Treatment of Anemia Due to IPSS-R Very Low, Low, or Intermediate Risk Myelodysplastic Syndromes in ESA-naïve Adult Participants Who Require Red Blood Cell Transfusions
Protocol code: TAK-226-3001
Sponsor: Takeda Development Center Americas Inc. (Pharmaceutical company). Phase: Therapeutic confirmatory (Phase III). Countries: France (authorised, recruitment pending), Belgium (authorised, recruitment pending), Germany (authorised, recruitment pending), Italy (ongoing, recruiting), Bulgaria (ongoing, recruiting), Ireland (authorised, recruitment pending), Lithuania (authorised, recruitment pending), Norway (authorised, recruitment pending), Romania (ongoing, recruiting), Hungary (authorised, recruitment pending), Spain (authorised, recruitment pending), Greece (authorised, recruitment pending), Poland (ongoing, recruiting), Netherlands (authorised, recruitment pending).
Therapeutic area(s): Diseases [C] - Hemic and Lymphatic Diseases [C15]
Gender: Female, Male. Age: 18-64 years, 65+ years. Enrolment: 114.
Start date (EU): 2026-06-02. Decision date: 2026-04-17. Results received: No. Last updated: 2026-07-02.
Decision dates by country: BG: 2026-04-28, DE: 2026-04-27, LT: 2026-04-22, NO: 2026-04-21, PL: 2026-04-28, FR: 2026-04-28, HU: 2026-04-30, IT: 2026-04-30, NL: 2026-04-17, ES: 2026-04-21, GR: 2026-04-17, IE: 2026-05-01, RO: 2026-05-05, BE: 2026-04-21

Condition(s): Myelodysplastic neoplasms/syndromes (MDS)
Product: ERYTHROPOIETIN, Elritercept

Primary endpoint: Proportion of participants who are RBC-TI for any consecutive ≥12-week period from Cycle 1 Day 1 (C1D1) through Week 24 with concurrent mean Hgb increase ≥1.5 g/dL from baseline
Endpoint(s): Key Secondary Endpoint: Proportion of participants who are RBC-TI for any consecutive ≥16-week period from C1D1 through Week 24., Key Secondary Endpoint: Proportion of participants who are RBC-TI for any consecutive ≥12-week period from C1D1 through Week 24., Key Secondary Endpoint: Proportion of participants who are RBC-TI for a consecutive 24-week period from C1D1., For further details please refer to the Protocol

Source: https://euclinicaltrials.eu/ctis-public/view/2025-523544-12-00